EU clinical trial 2024-511497-79-00: A Phase 2 study of alisertib in combination with endocrine therapy in patients with HR+, HER2-negative recurrent or metastatic breast cancer
Protocol code: PUMA-ALI-1201
Sponsor: Puma Biotechnology Inc. (Pharmaceutical company). Phase: Therapeutic exploratory (Phase II). Countries: Spain (ongoing, recruiting), Portugal (ongoing, recruiting).
Therapeutic area(s): Diseases [C] - Neoplasms [C04]
Gender: Female, Male. Age: 18-64 years, 65+ years. Enrolment: 54.
Status: Ongoing, recruiting. Start date (EU): 2024-12-30. Decision date: 2024-10-01. Results received: No. Last updated: 2025-12-23.
Decision dates by country: PT: 2024-10-04, ES: 2024-10-01

Condition(s): Hormone receptor positive (HR+), human epidermal growth factor receptor 2 negative (HER2-) recurrent or metastatic breast cancer (MBC)
Product: Fulvestrant STADA 250 mg injekcinis tirpalas užpildytame švirkšte, Alisertib Enteric-Coated Tablets, Exemestane SanoSwiss 25 mg plėvele dengtos tabletės, Anastrozole Accord 1 mg plėvele dengtos tabletės, Letrozole SanoSwiss 2,5 mg plėvele dengtos tabletės, Tamoxifen EBEWE 20 mg tabletės

Primary endpoint: Adverse events (AEs) and serious adverse events (SAEs) per National Cancer Institute Common Terminology Criteria for Adverse Events version 5.0 (NCI CTCAE v.5.0), Objective response rate (ORR), duration of response (DOR), disease control rate (DCR), progression free survival (PFS), and overall survival (OS)
Endpoint(s): ORR, DOR, DCR, PFS, and OS within biomarker-defined subgroups from retrospectively evaluated patient samples, Plasma alisertib concentrations collected on C1D1, C1D3, C1D8, and C1D18.

Source: https://euclinicaltrials.eu/ctis-public/view/2024-511497-79-00